EU clinical trial 2024-512154-24-00: A PILOT PROOF-OF–CONCEPT STUDY TO ASSESS THE EFFICACY AND SAFETY OF A 6 MONTHS RAVULIZUMAB TREATMENT IN PATIENTS WITH FLARES OF CORTICOSTEROID-RESISTANT IDIOPATHIC IgA NEPHROPATHY
Protocol code: RAV-IgA
Sponsor: Institut De Recerca Biomedica De Lleida Fundacio Dr. Pifarre (Laboratory/Research/Testing facility). Phase: Phase III and phase IV (Integrated). Countries: Spain (ended).
Therapeutic area(s): Diseases [C] - Female Urogenital Diseases and Pregnancy Complications [C13]
Gender: Female, Male. Age: 18-64 years, 65+ years. Enrolment: 15.
Status: Ended. Start date (EU): 2023-05-26. End date (EU): 2025-01-15. Decision date: 2024-06-28. Results received: No. Last updated: 2024-06-28.

Condition(s): IgA nephropathy
Product: Ultomiris 300 mg/30 mL concentrate for solution for infusion

Primary endpoint: Quantitative reduction of proteinuria and haematuria (based on 24-hr urine collection(s)) from baseline to Week 26 (6 months after starting treatment with ravulizumab)
Endpoint(s): Percentage of participants achieving complete remission 26 weeks after treatment with ravulizumab, Evolution of proteinuria and haematuria (based on 24- hr urine collection(s)) after treatment withdrawal (from Week 26 to Week 46), To measure the evolution of serum creatinine levels (quantitative) from baseline to Week 46, To measure the evolution of urine C5b-9 levels (quantitative) from baseline to Week 46, To measure the slope of eGFR computed from baseline to Week 46, Proportion of patients discontinuing treatment with ravulizumab due to adverse effects associated with the drug

Source: https://euclinicaltrials.eu/ctis-public/view/2024-512154-24-00